EU clinical trial 2024-511409-42-00: Combination therapy of 5-Fluorouracil and Calcipotriol versus 5-Fluorouracil in the treatment of Actinic Keratosis: a multicentre randomized controlled clinical trial
Sponsor: University Hospital Maastricht (Hospital/Clinic/Other health care facility). Phase: Therapeutic use (Phase IV). Countries: Netherlands (ongoing, recruitment ended).
Therapeutic area(s): Diseases [C] - Skin and Connective Tissue Diseases [C17]
Gender: Female, Male. Age: 18-64 years, 65+ years. Enrolment: 232.
Status: Ongoing, recruitment ended. Start date (EU): 2024-09-02. Decision date: 2024-06-13. Results received: No. Last updated: 2026-03-23.

Condition(s): Actinic Keratosis
Product: Efudix 5% cream., Calcipotriol Ointment 50 micrograms/g

Primary endpoint: The main trial endpoint is the proportion of patients achieving treatment success at 12 months post-treatment. Treatment success is defined as ≥75% reduction in the number of AK lesions in the treatment area (partial clearance).
Endpoint(s): The proportion of patients achieving treatment success at 3 months post-treatment. Treatment success is defined as ≥75% reduction in the number of AK lesions in the treatment area (partial clearance)., The proportion of patients achieving 100% clearance of AK lesions (complete clearance) at 3 and 12 months post-treatment., The mean percentage change in AK lesions compared to baseline, measured at 3 and 12 months post-treatment, The mean change in Actinic Keratosis Area and Severity Index (AKASI) score compared to baseline, measured at 3 and 12 months post-treatment, Recurrence rate, defined as the proportion of patients with new lesions at 3 and 12 months post-treatment, The proportion of patients who need retreatment within 12 months after finishing treatment, The proportion of patients experiencing moderate to severe adverse effects, as reported by the patients in their treatment diary and at 3 months post-treatment., Patient satisfaction with treatment at 3 and 12 months post-treatment, expressed as the proportion of patients who indicate to be satisfied with their treatment., Mean score for quality of life on the Skindex-17 questionnaire at baseline, 1 week after finishing treatment and 3 and 12 months post-treatment., Treatment adherence expressed as proportion of patients with complete adherence to the prescribed treatment regimen., Exploratory endpoint: the long-term probability of cSCC development, expressed as the 3-year cumulative probability of cSCC development.

Source: https://euclinicaltrials.eu/ctis-public/view/2024-511409-42-00